EU clinical trial 2025-522777-10-00: A Phase 2/3 randomized, open-label study of MK-1045 in combination with rituximab in patients with 1L follicular lymphoma.
Protocol code: MK-1045-007
Sponsor: Merck Sharp & Dohme LLC (Pharmaceutical company). Phase: Phase II and Phase III (Integrated). Countries: France (authorised, recruitment pending), Spain (ongoing, recruiting), Greece (authorised, recruitment pending).
Therapeutic area(s): Diseases [C] - Neoplasms [C04]
Gender: Female, Male. Age: 18-64 years, 65+ years. Enrolment: 9.
Start date (EU): 2026-06-19. Decision date: 2026-06-09. Results received: No. Last updated: 2026-08-07.
Decision dates by country: ES: 2026-06-11, GR: 2026-08-07, FR: 2026-06-09

Condition(s): Follicular Lymphoma
Product: MK-1045, PREDNISOLONE, CYCLOPHOSPHAMIDE, PREDNISONE, TOCILIZUMAB, Truxima 500 mg concentrate for solution for infusion, RITUXIMAB, MK-1045, Truxima 500 mg concentrate for solution for infusion, VINCRISTINE, DOXORUBICIN, BENDAMUSTINE, Ruxience 500 mg concentrate for solution for infusion, Truxima 100 mg concentrate for solution for infusion, Ruxience 100 mg concentrate for solution for infusion

Primary endpoint: Part 1: Number of Participants Who Experience an Adverse Event (AE), Part 1: Number of Participants Who Discontinue Study Treatment Due to an AE, Part 1: Number of Participants Who Experience Dose Limiting Toxicity (DLT), Part 1: Complete Response (CR) Rate, Part 2: Progression-Free Survival (PFS)
Endpoint(s): Part 1: Objective Response Rate (ORR), Part 1: Duration of CR, Part 1: Area Under the Concentration-Time Curve at Steady State (AUCss) of MK-1045, Part 1: Maximum Concentration (Cmax) of MK-1045, Part 1: Trough Concentration (Ctrough) of MK-1045, Part 2: CR Rate at 30 Months, Part 2: ORR, Part 2: Overall Survival (OS), Part 2: Event-Free Survival (EFS), Part 2: Duration of CR, Part 2: Number of Participants Who Experience an AE, Part 2: Number of Participants Who Discontinue Study Treatment Due to an AE, Part 2: Change From Baseline in Health-Related Quality Of Life (HRQoL) on Functional Assessment of Cancer Therapy-Lymphoma (FACT-Lym) Trial Outcome Index (TOI), Part 2: Change From Baseline in HRQoL on FACT-Lym Total Score, Part 2: Change From Baseline in HRQoL on FACT-Lym Physical Well-being (PWB) (Items General Physical [GP]1 Through GP7)

Source: https://euclinicaltrials.eu/ctis-public/view/2025-522777-10-00